EU clinical trial 2023-505349-26-00: Impact of low dose epinephrine in the management of out-of-hospital cardiac arrest on neurological outcome: A multicenter randomized and double-blind trial (Low-EPI Study)
Protocol code: 2021PI170
Sponsor: CHRU De Nancy (Hospital/Clinic/Other health care facility). Phase: Therapeutic confirmatory (Phase III). Countries: France (authorised, recruitment pending).
Therapeutic area(s): Diseases [C] - Cardiovascular Diseases [C14]
Gender: Female, Male. Age: 18-64 years, 65+ years. Enrolment: 4336.
Status: Authorised, recruitment pending. Decision date: 2025-10-08. Results received: No. Last updated: 2026-05-20.

Condition(s): Out-of-hospital cardiac arrest.
Product: ADRENALINE RENAUDIN 0,50 mg/ml, solution injectable, ADRENALINE RENAUDIN 1 mg/ml, solution injectable en ampoule

Primary endpoint: 28-day survival with a favorable neurological function defined as a Modified Rankin Scale (mRS) of score 2 or less at 28-days.
Endpoint(s): The secondary endpoints are: • Return of Spontaneous Circulation, assessed during cardiopulmonary resuscitation (CPR) and defined as a clinical assessment that shows signs of life, including palpable pulse or generating a blood pressure. • Survival at hospital admission. • 28-day survival. • Modified Rankin Scale (mRS) score used as a continuous variable (in contrast with the use of the mRS scale in the primary outcome).

Source: https://euclinicaltrials.eu/ctis-public/view/2023-505349-26-00